EU clinical trial 2024-513102-57-00: A Phase III randomized controlled trial comparing the efficacy, safety and tolerability of two formulations of vaginal micronized progesterone.
Protocol code: FSD-MIC-2022-03
Sponsor: Santiago Dexeus Font Fundacio Privada (Laboratory/Research/Testing facility). Phase: Therapeutic confirmatory (Phase III). Countries: Spain (ongoing, recruiting).
Therapeutic area(s): Diseases [C] - Female Urogenital Diseases and Pregnancy Complications [C13]
Gender: Female. Age: 18-64 years. Enrolment: 1020.
Status: Ongoing, recruiting. Start date (EU): 2023-07-05. Decision date: 2024-04-23. Results received: No. Last updated: 2025-11-07.

Condition(s): infertility
Product: PROGESTERONE, MICRONISED, Lugesteron 400 mg pehmeät emätinpuikot, kapselit, Estradiol Besins 0,75 mg/dose, gel transdermique, PROGESTERONE, MICRONISED

Primary endpoint: The primary efficacy endpoint is the comparison of ongoing pregnancy rate. The primary efficacy endpoint is related to the primary trial objective.
Endpoint(s): Implantation rate, Biochemical pregnancy rate, Clinical pregnancy rate, Miscarriage rate, Frequency of adverse events

Source: https://euclinicaltrials.eu/ctis-public/view/2024-513102-57-00